EU clinical trial 2024-515195-12-00: A Mass Balance Study of [14C]-IPN60250 in Healthy Adult Participants
Protocol code: CLIN-60250-451
Sponsor: Ipsen Pharma (Pharmaceutical company). Phase: Human Pharmacology (Phase I)- Other. Countries: Netherlands (ended).
Therapeutic area(s): Diseases [C] - Digestive System Diseases [C06]
Gender: Male. Age: 18-64 years. Enrolment: 7.
Status: Ended. Start date (EU): 2025-02-18. End date (EU): 2025-04-14. Decision date: 2025-01-29. Results received: No. Last updated: 2026-06-11.

Condition(s): Primary sclerosing cholangitis (PSC)

Source: https://euclinicaltrials.eu/ctis-public/view/2024-515195-12-00